EU clinical trial 2023-505143-39-00: Short-term changes in cardiovascular risk determinants after temporarily stopping gender-affirming hormone therapy in older transgender women - a pilot study
Protocol code: NL81591.018.22
Sponsor: Amsterdam UMC (Hospital/Clinic/Other health care facility). Phase: Therapeutic use (Phase IV). Countries: Netherlands (ended).
Therapeutic area(s): Psychiatry and Psychology [F] - Psychological Phenomena [F02]; Diseases [C] - Cardiovascular Diseases [C14]
Gender: Female. Age: 18-64 years, 65+ years. Enrolment: 30.
Status: Ended. Start date (EU): 2024-02-23. End date (EU): 2025-09-29. Decision date: 2023-09-15. Results received: No. Last updated: 2023-09-15.

Condition(s): Transgender women using long-term gender-affirming hormone therapy
Product: Estradiol Sandoz pleister 50 µg/24 uur, pleisters voor transdermaal gebruik 4 mg/20 cm2, Oestrogel 0,75 mg/dosis, transdermale gel, Systen 75, pleisters voor transdermaal gebruik 75 microgram/24 uur, Estradiol Sandoz tablet 2 mg, filmomhulde tabletten, Progynova 2 mg, omhulde tabletten, Lenzetto 1,53 mg/dosis, spray voor transdermaal gebruik, oplossing, Progynova 1 mg, omhulde tabletten, Estradiol Sandoz pleister 100 µg/24 uur, pleisters voor transdermaal gebruik 8 mg/40 cm2, Systen 50, pleisters voor transdermaal gebruik 50 microgram/24 uur, Systen 100, pleisters voor transdermaal gebruik 100 microgram/24 uur

Primary endpoint: cardiovascular risk determinants: height, weight, body mass index (BMI), bioelectrical impedance analysis, blood pressure, heart rate, and laboratory measures including total cholesterol, HDL cholesterol, LDL cholesterol, triglycerides, and haematocrit
Endpoint(s): grip strength and varying determinants of general wellbeing, including Satisfaction with Life Scale, Subjective Happiness Scale, PROMIS Emotional Distress – Anxiety – Short Form 8a, PROMIS Emotional Distress – Depression – Short Form 8b, World Health Organization Quality of Life Assessment (WHO-QoL BREF), Pittsburgh sleep quality index, Body Image Scale, The hormonal symptoms questionnaire including an extra question about perceived skin changes and questions regarding an overall evaluation of perceived changes and experiences due to stopping/restarting GHT, General information including age, type and dose of estradiol therapy, surgical status (i.e., type of gonadectomy), cardiovascular morbidity, and medication, Lifestyle factors (i.e., smoking, alcohol consumption, physical activity by means of Baecke Activity Questionnaire) and laboratory measures including 17-beta estradiol (pmol/l), luteinizing hormone (E/l), follicle stimulating hormone (E/l), testosterone (nmol/l), Three extra blood samples per visit for storage in the established gender biobank

Source: https://euclinicaltrials.eu/ctis-public/view/2023-505143-39-00